EU clinical trial 2023-503803-27-00: A Phase 3b, Multicenter, Open-label, PCI-32765 (Ibrutinib) Long-term Extension Study
Protocol code: PCI-32765CAN3001
Sponsor: Janssen - Cilag International (Pharmaceutical company). Phase: Therapeutic confirmatory (Phase III). Countries: France (ongoing, recruiting), Spain (ongoing, recruiting), Germany (ongoing, recruiting), Portugal (ended), Italy (ended), Belgium (ongoing, recruiting), Greece (ended), Poland (ongoing, recruiting).
Therapeutic area(s): Diseases [C] - Neoplasms [C04]
Gender: Female, Male. Age: 18-64 years, 65+ years. Enrolment: 137.
Start date (EU): 2013-10-25. Decision date: 2023-10-24. Results received: No. Last updated: 2026-05-20.
Decision dates by country: GR: 2023-12-04, IT: 2023-10-27, FR: 2023-10-25, DE: 2023-10-25, ES: 2023-10-24, PL: 2023-12-14, BE: 2023-10-25, PT: 2023-10-25

Condition(s): B-cell non-Hodgkin's lymphoma and cGVHD
Product: OPDIVO 10 mg/mL concentrate for solution for infusion., Ibrutinib - capsule - 140 mg

Primary endpoint: Number of participants affected by an adverse event
Endpoint(s): Number of participants with change in disease status

Source: https://euclinicaltrials.eu/ctis-public/view/2023-503803-27-00